EU clinical trial 2024-511295-33-00: Study to evaluate the effect of metformin in the prevention of hyperglycemia in HR[+]/HER2[–] PIK3CA-mutated advanced breast cancer patients treated with alpelisib plus endocrine therapy. The Metallica study.
Protocol code: MEDOPP240
Sponsor: Medica Scientia Innovation Research S.L. (Pharmaceutical company). Phase: Therapeutic exploratory (Phase II). Countries: Spain (ended).
Therapeutic area(s): Diseases [C] - Neoplasms [C04]
Gender: Female, Male. Age: 18-64 years, 65+ years. Enrolment: 88.
Status: Ended. Start date (EU): 2020-08-13. End date (EU): 2025-03-16. Decision date: 2024-04-15. Results received: Yes. Last updated: 2025-02-03.

Condition(s): Study to evaluate the effect of metformin in the prevention of hyperglycemia in HR[+]/HER2[–] PIK3CA-mutated advanced breast cancer patients treated with alpelisib plus endocrine therapy. The Metallica study.
Product: Exemestano Kern Pharma 25 mg comprimidos recubiertos con película EFG, Letrozol Kern Pharma 2,5 mg comprimidos recubiertos con película EFG, ALPELISIB, ALPELISIB, Vildagliptina Kern Pharma 50 mg comprimidos EFG, tamoxifeno cinfa 20 mg comprimidos EFG, Fulvestrant Teva 250 mg solución inyectable en jeringa precargada EFG, Metformina Kern Pharma 1000 mg comprimidos recubiertos con película EFG, ALPELISIB

Primary endpoint: Cohorts A and B: The rate of patients with grade 3-4 HG is defined as the number of patients with fasting plasma glucose (FPG) or fasting selfmonitoring blood glucose (SMBG) > 250 mg/dL (13,9 mmol/L) over the first 8 weeks of alpelisib treatment, determined locally by the investigator using CTCAE v.4.03 divided by the number of evaluable patients in the Cohorts A and B., Cohort C: The rate of patients with permanent discontinuation of alpelisib due to related AEs (according to CTCAE v.4.03) over the first 8 weeks of treatment with alpelisib.
Endpoint(s): Efficacy PFS, defined as the time from the date of inclusion to the date of the first documented progression or death due to any cause, in the overall population, in all cohorts, and according to the different endocrine agent received. If a patient has not had an event, PFS will be censored at the date of the last adequate tumor evaluation [see RECIST 1.1]., Efficacy ORR, defined as the proportion of patients with measurable disease with best overall response –including complete response [CR] or partial response [PR]– based on local investigator’s assessment (RECIST 1.1), in the overall population, in all cohorts, and according to the different endocrine agent received., Efficacy TTR, defined as the period from the treatment initiation to time of the first objective tumor response (tumor shrinkage of ≥ 30%) observed for patients who achieved a CR or PR, as determined locally by the investigator through the use of RECIST v.1.1.· in all the cohorts, and according to the different endocrine agent received., Efficacy TTP, defined as the time from date of start of treatment to the date of event defined as the first documented progression or death due to underlying cancer, in the overall population, in all cohorts, and according to the different endocrine agent received. If a patient has not had an event, time to progression is censored at the date of last adequate tumor assessment)., Efficacy CBR, defined as the proportion of patients with a best overall response of CR or PR or SD or Non-CR/Non-PD lasting more than 24 weeks based on local investigator assessment, in the overall population, in all cohorts, and according to the different endocrine agent received., Safety The rate of any grade and grade 3-4 HG by CTCAE v.4.03 in Cohorts A, B, and C for Metallica, and its comparation with Solar-1, Bylieve trials., Safety Rate of patients with alpelisib permanent discontinuation due to related AEs over the first 8 weeks in the overall population, in all and according to the different endocrine agent received., Safety Rate of patients with grade 3-4 HG as per CTCAE v.4.03 over the first 8 weeks of treatment with alpelisib plus endocrine therapy and antidiabetic treatment and during the whole study, in all study cohorts according to the different endocrine agent received., Safety Rate of patients that requires insulin to control HG during the first 8 weeks and throughout the study, in the overall population, in all the cohorts, and according to the different endocrine agent received., Safety The number and class of antidiabetic agents used during the first 8 weeks and throughout the study, in the overall population, in all the cohorts., Safety Rate of patients with HG in all the cohorts and according to the different endocrine agent received as per CTCAE v.4.03 and as per CTCAE v.5., Safety The rate of any grade and grade 3-4 diarrhea by CTCAE v.4.03, Safety AEs in the overall population, in all the cohorts, and according to the different endocrine agent received as per CTCAE v.4.03., Safety Safety and tolerability of the combination of alpelisib with endocrine therapy, and antidiabetic treatment in all study cohorts and according to the different endocrine agent received., Safety Cutaneous rash by CTCAE v.4.03 over the first 8 weeks and rate of patients requiring active treatment with antihistaminic for control and prevention in the overall population, in all the cohorts, and according to the different endocrine agent received., Safety Diarrhea by CTCAE v.4.03 over the first 8 weeks and rate of patients requiring active treatment with loperamide and/or other measures for control and prevention in the overall population, in all the cohorts, and according to the different endocrine agent received., Safety Fasting plasma glucose, SMBG, ketones, C peptide, and continuous monitoring analytical parameters evaluated at baseline and during treatment periods in all patients and in all study cohorts.

Source: https://euclinicaltrials.eu/ctis-public/view/2024-511295-33-00